EU clinical trial 2024-510678-25-00: Impact of long-acting injectable cabotegravir for HIV pre-exposure prophylaxis persistence and coverage in men who have sex with men in France: a randomized controlled clinical trial.
Protocol code: ANRS 0410s
Sponsor: Inserm (Laboratory/Research/Testing facility). Phase: Phase III and phase IV (Integrated). Countries: France (ongoing, recruitment ended).
Therapeutic area(s): Health Care [N] - Health Care Quality, Access, and Evaluation [N05]
Gender: Male. Age: 18-64 years, 65+ years. Enrolment: 322.
Status: Ongoing, recruitment ended. Start date (EU): 2025-05-14. Decision date: 2024-09-24. Results received: No. Last updated: 2025-11-14.

Condition(s): HIV prevention
Product: Apretude 600 mg prolonged-release suspension for injection, Truvada 200 mg/245 mg film-coated tablets, Apretude 30 mg film-coated tablets

Primary endpoint: Completion of all protocol visits at Month 12 with a documented PrEP prescription of CAB or TDF/FTC at each study aligned with the randomization arm.
Endpoint(s): Completion of all protocol visits at Month 24 with a documented PrEP prescription of CAB or TDF/FTC at each study aligned with the randomization arm, Causes of non-sustained PrEP use over time: missing follow-up visits defined by a visit occurring more than 15 days after the scheduled date, temporary PrEP discontinuation, permanent PrEP discontinuation, switching to another PrEP regimen different from the randomization arm, study discontinuation with PrEP cessation, study discontinuation while maintaining PrEP, and lost to follow-up., PrEP coverage of the last condomless anal sexual intercourse based on self-report at each study visits. This information will be collected in the study eCRF., Satisfaction regarding PrEP regimen measured by a self-administered questionnaire at baseline, 12 and 24 months, Number of sexual partners in the last 3 months evaluated by a self-administered questionnaire before the visits at baseline, 6, 12, 18 and 24 months., Number of condomless anal sexual intercourse in the month prior each study visits. This information will be collected in the study eCRF., Occurrence of syphilis, chlamydia, and gonorrhea infections at any time during the study., Weight, blood pressure, fasting lipid level and HOMA index measured at baseline, 12, and 24 months., Occurrence of Grade 2 or higher clinical or laboratory drug-related adverse events at any time during the study., Injection site reaction and its severity evaluated by the investigator at each injection visits., Perception of pain and injection site reactions by participants measured through a self-administrated questionnaire at baseline, 6, 12, 18 and 24 months., PrEP regimen used in the month prior to each study visits (TDF/FTC: daily or on-demand, CAB group: CAB oral or CAB-LA). This information will be collected in the study eCRF., Concentration of tenofovir diphosphate (TFV-DP) and emtricitabine triphosphate (FTC-TP) in dried blood spots (DBS) at baseline., Drugs concentrations in plasma measured at Months 6, 12, 18 and 24: o CAB Group: cabotegravir concentration in plasma. o TDF/FTC group: tenofovir diphosphate (TFV-DP) and emtricitabine triphosphate (FTC-TP) concentration in dried blood spots (DBS)., Study visits occurring “on-time” (At Month 1: ±3 days, other visits: ±7 days)., Occurrence of HIV infection at any time during the study, defined as a positive HIV antibody immunoassay (4th generation) confirmed by the presence of HIV ribonucleic acid (RNA)., HIV drug resistance mutations among HIV-infected participants., Use of psychoactive drugs in the last 3 months evaluated by a self-administered questionnaire before the visits at baseline, 6, 12, 18 and 24 months., Quality of life measured by the EuroQol-5D questionnaire at baseline, 12 and 24 months., Mental health measured by the Center for Epidemiologic Studies Depression Scale and the Rosenberg self-esteem scale at baseline, 12 and 24 months., PrEP knowledge score evaluated by a self-administered questionnaire at baseline, 12 and 24 months., Number and nature of uses of community peer support and therapeutic patient education measured through a self-administrated questionnaire at baseline, 6, 12, 18 and 24 months.

Source: https://euclinicaltrials.eu/ctis-public/view/2024-510678-25-00